EU clinical trial 2024-517622-25-00: PEACE2 : A randomized Phase III, factorial design, of cabazitaxel and pelvic radiotherapy in patients with localized prostate cancer and high-risk features of relapse
Sponsor: Unicancer (Hospital/Clinic/Other health care facility). Phase: Therapeutic confirmatory (Phase III). Countries: Belgium (ongoing, recruitment ended), France (ongoing, recruitment ended), Spain (ongoing, recruitment ended).
Therapeutic area(s): Diseases [C] - Neoplasms [C04]
Gender: Male. Age: 18-64 years, 65+ years. Enrolment: 760.
Status: Ongoing, recruitment ended. Start date (EU): 2013-12-06. Decision date: 2024-11-04. Results received: No. Last updated: 2024-12-13.
Decision dates by country: BE: 2024-11-04, FR: 2024-12-13, ES: 2024-11-19

Condition(s): Patients with localized prostate cancer and high-risk features of relapse.
Product: JEVTANA 60 mg concentrate and solvent for solution for infusion.

Primary endpoint: La supervivencia específica del cáncer de próstata se calculará entre la fecha de aleatorización y la fecha de la muerte por el cáncer de próstata.
Endpoint(s): The prostate-specific antigen response at 3 months will be defined as a serum PSA value (≤ 0.2 ng/mL), The biochemical progression-free survival is defined as the time from randomization to the date of PSA relapse (evaluated according to Phoenix criteria i.e. nadir + 2 ng/mL) or death., The metastases-free survival is defined as the time from randomization to the date of the appearance of the metastases on imaging (mainly bone scan and CT-scan) or death., The local relapse-free survival is defined as the time from randomization to the date of the appearance of the first local relapse or death., The overall survival will be calculated from the date of randomization to the date of death from any cause or date of the last follow-up., The prostate cancer-specific survival will be calculated from the date of randomization to the date of the death due to prostate cancer, The acute toxicity (i.e. during the treatment period), will be evaluated according to the NCI-CTC v4.0 criteria, The impact of treatment on serum testosterone will be evaluated at baseline, 6 months then yearly., The long-term toxicity (potency, cardiac, hot flashes and late toxicity related to radiotherapy or chemotherapy) will be evaluated at 1 year, 2 years and 5 years. The toxicity related to the radiotherapy will be assessed using NCI-CTC v4.0 criteria., The predictive biomarkers of treatment efficacy will be assessed on archival biopsy specimens, The quality of life will be evaluated with the QLQ –C30 and PR25 questionnaires at baseline, 6 months then yearly up to 10 years after the randomization date.

Source: https://euclinicaltrials.eu/ctis-public/view/2024-517622-25-00